EU clinical trial 2023-506407-26-00: Trial to evaluate the administration of IDOR-1134-2831 vaccine in healthy participants
Protocol code: ID-090-101
Sponsor: Idorsia Pharmaceuticals Ltd. (Pharmaceutical company). Phase: Human Pharmacology (Phase I)- First administration to humans. Countries: Germany (ended).
Therapeutic area(s): Diseases [C] - Bacterial Infections and Mycoses [C01]
Gender: Female, Male. Age: 18-64 years. Enrolment: 60.
Status: Ended. Start date (EU): 2024-05-28. End date (EU): 2026-03-19. Decision date: 2024-04-16. Results received: No. Last updated: 2025-08-20.

Condition(s): Clostridioides difficile (C. difficile)

Source: https://euclinicaltrials.eu/ctis-public/view/2023-506407-26-00